EU clinical trial 2023-506074-12-00: A Randomized, Double-Blind, Phase 3 Study of Pembrolizumab/Vibostolimab Coformulation (MK-7684A) in Combination with Chemotherapy Versus Pembrolizumab Plus Chemotherapy as First Line Treatment for Participants with Metastatic Non-Small Cell Lung Cancer (MK-7684A-007/KEYVIBE-007)
Protocol code: MK-7684A-007
Sponsor: Merck Sharp & Dohme LLC (Pharmaceutical company). Phase: Therapeutic confirmatory (Phase III). Countries: Germany (ended), Spain (ended), Austria (ended), France (ended), Poland (ended).
Therapeutic area(s): Diseases [C] - Neoplasms [C04]
Gender: Female, Male. Age: 18-64 years, 65+ years. Enrolment: 190.
Status: Ended. Start date (EU): 2022-03-22. End date (EU): 2025-12-23. End date: 2026-01-09. Decision date: 2023-09-29. Results received: No. Last updated: 2025-12-23.
Decision dates by country: ES: 2023-09-29, DE: 2023-09-29, FR: 2023-10-26, PL: 2023-11-10, AT: 2023-10-09

Condition(s): Metastatic Non-Small Cell Lung Cancer
Product: Pazenir 5 mg/ml powder for dispersion for infusion., PEMETREXED, PACLITAXEL, CISPLATIN, CARBOPLATIN, ALIMTA 500 mg powder for concentrate for solution for infusion, KEYTRUDA 25 mg/mL concentrate for solution for infusion, PACLITAXEL, MK-7684A, Abraxane 5 mg/ml powder for dispersion for infusion.

Primary endpoint: Overall Survival (OS) in Participants with Programmed Cell Death-Ligand 1 (PD-L1) Tumor Proportion Score (TPS) ≥1%
Endpoint(s): Overall Survival (OS), Progression-Free Survival (PFS), Objective Response Rate (ORR), Change from Baseline in the Global Health Status/Quality of Life (Items 29 and 30) Combined Score on the European Organization for Research and Treatment of Cancer Quality of Life Questionnaire-Core 30 (EORTC QLQ-C30), Change from Baseline in Physical Functioning (Items 1-5) Combined Score on the EORTC QLQ-C30, Change from Baseline for Role Functioning (Items 6 and 7) Combined Score on the EORTC QLQ-C30, Change from Baseline in Dyspnea Score (Item 8) on the EORTC QLQ-C30, Change from Baseline in Cough Score (Item 31) on the European Organization for Research and Treatment of Cancer Quality of Life Lung Cancer-Specific Questionnaire Module (EORTC QLQ-LC13), Change from Baseline in Chest Pain Score (Item 40) on the EORTC QLQ- LC13, Time to Deterioration (TTD) in the Global Health Status/Quality of Life (Items 29 and 30) Combined Score on the EORTC QLQ-C30, TTD in Physical Functioning (Items 1-5) Combined Score on the EORTC QLQ- C30, TTD in Role Functioning (Items 6 and 7) Combined Score on the EORTC QLQ-C30, TTD in Dyspnea Score (Item 8) on the EORTC QLQ-C30, TTD in Cough Score (Item 31) on the EORTC QLQ-LC13, TTD in Chest Pain Score (Item 40) on the EORTC QLQ-LC13, Number of Participants Who Experienced One or More Adverse Events (AEs), Number of Participants Who Discontinued Study Intervention Due to an AE, Duration of Response (DOR)

Source: https://euclinicaltrials.eu/ctis-public/view/2023-506074-12-00